EU clinical trial 2026-525810-80-00: An Open-Label Study to Assess the Hemodynamic Effect and the Safety of TX000045 After 16 Weeks of Treatment in Participants With Pulmonary Hypertension due to Interstitial Lung Disease
Protocol code: TX000045-004
Sponsor: Tectonic Operating Company Inc. (Pharmaceutical company). Phase: Therapeutic exploratory (Phase II). Countries: Poland (authorised, recruitment pending), Romania (authorised, recruitment pending), Spain (authorised, recruitment pending).
Therapeutic area(s): Diseases [C] - Cardiovascular Diseases [C14]
Gender: Female, Male. Age: 18-64 years, 65+ years. Enrolment: 9.
Status: Authorised, recruitment pending. Decision date: 2026-07-17. Results received: No. Last updated: 2026-07-20.
Decision dates by country: RO: 2026-07-20, ES: 2026-07-17, PL: 2026-07-20

Condition(s): Pulmonary hypertension secondary to interstitial lung disease
Product: TX000045

Primary endpoint: 1. Mean change from baseline in PVR after 16 weeks of treatment., 2. Incidence of AEs, AESIs, and SAEs, 3. Clinically significant changes from baseline in safety laboratory assessments including clinical chemistry, hematology, urinalysis, 12-lead ECG assessments, and vital sign assessments over the course of the study.
Endpoint(s): 1. Mean change from baseline in mPAP after 16 weeks of treatment, 2. Mean change from baseline in several hemodynamic parameters, including but not limited to CO and SV, after 16 weeks of treatment., 3. Mean change from baseline in resting arterial SpO2 over the course of the study., 4. Mean change from baseline in supplemental oxygen requirement (L/min) at rest over the course of the study., 5. Mean change from baseline in the nadir of the SpO2 during the 6MWT over the course of the study., 6. Mean change from baseline in SpO2 at 1, 2, and 3 minutes after completion of the 6MWT over the course of the study., 7. Mean change from baseline in the distance walked during the 6MWT at which there is an absolute decrease of SpO2 >4% for at least 15 seconds over the course of the study.

Source: https://euclinicaltrials.eu/ctis-public/view/2026-525810-80-00